EU clinical trial 2024-513015-27-00: A Phase III, Multicenter, Double-Blind, Placebo-Controlled Study to Assess the Efficacy and Safety of Induction Therapy with RO7790121 in Patients with Moderately to Severely Active Ulcerative Colitis
Protocol code: GA45330
Sponsor: F. Hoffmann-La Roche AG (Pharmaceutical company). Phase: Therapeutic confirmatory (Phase III). Countries: Denmark (ended), France (ongoing, recruitment ended), Croatia (ongoing, recruitment ended), Austria (ongoing, recruitment ended), Netherlands (ongoing, recruitment ended), Poland (ongoing, recruitment ended), Belgium (ongoing, recruitment ended), Slovakia (ended), Italy (ongoing, recruitment ended), Portugal (ongoing, recruitment ended), Romania (ended), Germany (ongoing, recruitment ended), Czechia (ongoing, recruitment ended), Bulgaria (ongoing, recruitment ended), Spain (ongoing, recruitment ended), Hungary (ongoing, recruitment ended).
Therapeutic area(s): Phenomena and Processes [G] - Immune System Phenomena [G13]; Diseases [C] - Digestive System Diseases [C06]
Gender: Female, Male. Age: 18-64 years, 65+ years. Enrolment: 217.
Start date (EU): 2025-01-09. Decision date: 2024-11-11. Results received: No. Last updated: 2026-06-16.
Decision dates by country: HR: 2024-11-15, BG: 2024-11-14, FR: 2024-11-15, AT: 2024-11-15, CZ: 2024-11-26, RO: 2024-12-05, HU: 2024-12-05, ES: 2024-12-05, IT: 2024-11-18, DK: 2024-11-12, DE: 2024-11-12, PL: 2024-11-13, BE: 2024-11-11, SK: 2024-11-12, PT: 2024-11-12, NL: 2024-11-13

Condition(s): Moderately to Severely Active Ulcerative Colitis (UC)
Product: RO7790121 Placebo (F09-01), RO7790121 Placebo, RO7790121, RO7790121, RO7790121

Primary endpoint: Clinical remission, defined as modified Mayo Score (mMS) ≤ 2 with stool frequency subscore (SFS) = 0 or 1, rectal bleeding subscore (RBS) = 0, and endoscopic subscore (ES) = 0 or 1, at Week 12
Endpoint(s): Stool Frequency Subscore (SFS) from baseline to Week 12, Rectal Bleeding Subscore (RBS) from baseline to Week 12, Partial modified Mayo Score (pmMS), defined as SFS + RBS, from baseline to Week 12, Symptomatic response, defined as a decrease in pmMS of at least 1 point and 30% from baseline, at Week 12, Endoscopic improvement, defined as ES = 0 or 1, at Week 12, Endoscopic remission, defined as ES = 0, at Week 12, Clinical response, defined as a decrease in mMS of at least 2 points and 30% from baseline and either a decrease in RBS ≥ 1 or RBS = 0 or 1, at Week 12, Histologic improvement, defined as Geboes ≤ 3.1 at Week 12, Histologic remission, defined as Geboes < 2B at Week 12, Histologic-endoscopic mucosal improvement, defined as Geboes ≤ 3.1 and ES = 0 or 1, at Week 12, Histologic-endoscopic remission, defined as Geboes < 2B and ES = 0 or 1, at Week 12, Among biomarker-defined subgroups of participants: - Clinical remission at Week 12, Among biomarker-defined subgroups of participants: - Endoscopic improvement at Week 12, Bowel urgency from baseline through Week 12, Abdominal pain from baseline through Week 12, Fatigue, as measured by Functional Assessment of Chronic Illness Therapy-Fatigue Scale (FACIT-F), from baseline to Week 12, Inflammatory Bowel Disease Questionnaire (IBDQ) from baseline to Week 12, Overall change in UC symptoms, as measured by Patient Global Impression of Change (PGIC), from baseline to Week 2 and Week 12, Overall severity in UC symptoms, as measured by Patient Global Impression of Severity (PGIS), from baseline to Week 2 and Week 12, Incidence and severity of the following: Adverse events, Incidence and severity of the following: Serious adverse events, Incidence and severity of the following: Adverse events leading to study treatment discontinuation, Incidence and severity of the following: Adverse events of special interest

Source: https://euclinicaltrials.eu/ctis-public/view/2024-513015-27-00